EU clinical trial 2023-503468-17-00: A Phase 1b Study of Subcutaneous Daratumumab Regimens in Combination with Bispecific T Cell Redirection Antibodies for the Treatment of Subjects with Multiple Myeloma
Protocol code: 64407564MMY1002
Sponsor: Janssen - Cilag International (Pharmaceutical company). Phase: Human Pharmacology (Phase I)- Other. Countries: Germany (ongoing, recruitment ended), Netherlands (ongoing, recruitment ended), Spain (ongoing, recruitment ended).
Therapeutic area(s): Diseases [C] - Neoplasms [C04]
Gender: Female, Male. Age: 18-64 years, 65+ years. Enrolment: 111.
Status: Ongoing, recruitment ended. Start date (EU): 2020-03-02. Decision date: 2024-06-07. Results received: No. Last updated: 2026-02-09.
Decision dates by country: DE: 2024-06-11, ES: 2024-06-10, NL: 2024-06-07

Condition(s): Multiple myeloma

Source: https://euclinicaltrials.eu/ctis-public/view/2023-503468-17-00